EU clinical trial 2023-505046-26-00: PRODIGE 88-CIRCULATE PAC: Phase III multicentric, open-label, randomized study to investigate the efficacy of chemotherapy in patients with positive ctDNA after surgery and adjuvant chemotherapy for a high-risk stage II and stage III Colorectal Cancer
Protocol code: PRODIGE 88
Sponsor: Centre Hospitalier Universitaire De Dijon (Hospital/Clinic/Other health care facility). Phase: Therapeutic confirmatory (Phase III). Countries: France (ongoing, recruiting).
Therapeutic area(s): Diseases [C] - Digestive System Diseases [C06]
Gender: Female, Male. Age: 18-64 years, 65+ years. Enrolment: 249.
Status: Ongoing, recruiting. Start date (EU): 2026-05-07. Decision date: 2023-09-11. Results received: No. Last updated: 2025-10-20.

Condition(s): Colon carcinoma
Product: FLUOROURACIL, Avastin 25 mg/ml concentrate for solution for infusion., Lonsurf 15 mg/6.14 mg film-coated tablets, Lonsurf 20 mg/8.19 mg film-coated tablets, FLUOROURACIL, IRINOTECAN, FOLINIC ACID

Primary endpoint: Time to recurrence (TTR), defined as time from randomization to disease recurrence, which includes locoregional or metastatic relapse, death with evidence of recurrence and death from colorectal cancer (CRC) cause
Endpoint(s): TTR (primary endpoint): will be defined as the time from randomization to disease recurrence including locoregional or metastatic relapse, death with evidence of recurrence and death from CRC cause. Patients alive without relapse or who had died from a cause other than CRC, will be censored at the date of last news., OS: will be defined as the time from randomization to death whatever the cause of death. Patients who are alive will be censored at the to date of last news., DFS: will be defined as the time from randomization to all causes of death, second primary colorectal cancers (CRCs), locoregional and metastatic relapse, but not second primary non-CRCs. Patients alive without relapse or second CR cancer or who died for other cause than CRC will be censored at date of last news, CtDNA clearance rate: will be defined as the percentage of patients with a clearance of ctDNA, The predictive value of baseline and early ctDNA clearance for long term oncological outcomes, Rate of secondary surgery/ablation for disease recurrence: will be defined as the percentage of patients with a secondary surgery/ablation after disease recurrence, Tolerability: Toxicities will be graded according to the NCI-CTCAE v 5.0 criteria before each cycle, Quality of life: Quality of life will be assessed according to the questionnaire of EORTC QLQ-C30 and EQ5D questionnaires. Survival without QoL deterioration is defined as the time between randomization and the occurrence of a deterioration, Recurrence rate: will be defined as the percentage of patients with a disease recurrence (including locoregional or metastatic relapse), and the rate of potentially curable recurrences will be defined as the percentage of patients with a potentially curable recurrence (i.e oligometastatic disease)

Source: https://euclinicaltrials.eu/ctis-public/view/2023-505046-26-00